EU clinical trial 2023-508948-22-00: A Mono-Center, Prospective Biomarker Study to investigate the differences in the inflammatory gene expression signature, the distribution of immune cells, psoriasis-driving factors and signaling molecules between classic and hard-to-treat psoriasis plaques and the effects of TYK2 blockade with deucravacitinib – MED-PSO
Protocol code: BMS-IM011-1101
Sponsor: Charite Universitaetsmedizin Berlin KöR (Hospital/Clinic/Other health care facility). Phase: Therapeutic use (Phase IV). Countries: Germany (ended).
Therapeutic area(s): Diseases [C] - Skin and Connective Tissue Diseases [C17]
Gender: Female, Male. Age: 18-64 years, 65+ years. Enrolment: 30.
Status: Ended. End date (EU): 2025-05-05. Decision date: 2025-01-17. Results received: Yes. Last updated: 2025-02-10.

Condition(s): moderate to severe plaque psoriasis
Product: SOTYKTU 6 mg film-coated tablets, SOTYKTU 6 mg film-coated tablets, SOTYKTU 6 mg film-coated tablets, SOTYKTU 6 mg film-coated tablets, SOTYKTU 6 mg film-coated tablets, SOTYKTU 6 mg film-coated tablets, SOTYKTU 6 mg film-coated tablets, SOTYKTU 6 mg film-coated tablets

Primary endpoint: The primary endpoint is a change in the expression of the genes IL-17A, IL-17F, IL-22, ß-defensin4A/b and KRT16 compared to baseline in both the classic and hard-to-treat plaques following the treatment with 6 mg Sotyktu® QD for 16 weeks.
Endpoint(s): • based on the expression of IL-17A, IL-17F, IL-19, IL-22, and IL-36A, the interleukin receptor IL-23R as well as ß-defensine-2 (DEFB4A/B), S100A8/9, KRT16, OASL, MX1, CXCL10, iNOS, CXCR3 and CCL20 as well as IL-31., • CD3 • CD4 • CD11c., • Ki67 • KRT16 • H&E, • STAT-1, • STAT-3 • STAT-4 • STAT-5, • Th1 • Th2 • Th17 • Th17.1 • Treg • DCs • MDSCs, • overall PASI • body site specific local PASI • inverse • scalp • palmoplantar, • Overall • pruritus, pain NRS

Source: https://euclinicaltrials.eu/ctis-public/view/2023-508948-22-00